EU clinical trial 2023-507906-15-00: An open-label, single arm, multi-center extension study evaluating long-term safety, tolerability and effectiveness of ofatumumab in subjects with relapsing multiple sclerosis (RMS)
Protocol code: COMB157G2399
Sponsor: Novartis Pharma AG (Pharmaceutical company). Phase: Therapeutic confirmatory (Phase III). Countries: Germany (ongoing, recruitment ended), Latvia (ongoing, recruitment ended), Norway (ongoing, recruitment ended), Belgium (ongoing, recruitment ended), Netherlands (ongoing, recruitment ended), Hungary (ongoing, recruitment ended), Portugal (ongoing, recruitment ended), Poland (ongoing, recruitment ended), Spain (ongoing, recruitment ended), Lithuania (ongoing, recruitment ended), Slovakia (ongoing, recruitment ended), Austria (ended), Sweden (ongoing, recruitment ended), Czechia (ongoing, recruitment ended), Bulgaria (ongoing, recruitment ended), Finland (ongoing, recruitment ended), Croatia (ongoing, recruitment ended), France (ongoing, recruitment ended), Denmark (ongoing, recruitment ended), Estonia (ongoing, recruitment ended), Greece (ongoing, recruitment ended).
Therapeutic area(s): Diseases [C] - Nervous System Diseases [C10]
Gender: Female, Male. Age: 18-64 years. Enrolment: 963.
Start date (EU): 2019-01-30. Decision date: 2024-07-19. Results received: No. Last updated: 2026-08-05.
Decision dates by country: LV: 2024-07-22, DK: 2024-07-22, FI: 2024-07-22, SK: 2024-07-23, NO: 2024-07-22, LT: 2024-07-24, SE: 2024-07-22, PT: 2024-07-19, HR: 2024-07-22, GR: 2024-10-01, PL: 2024-08-04, EE: 2024-07-23, NL: 2024-07-22, BE: 2024-07-22, AT: 2024-07-23, HU: 2024-07-22, FR: 2024-07-24, CZ: 2024-07-24, BG: 2024-07-19, ES: 2024-07-22, DE: 2024-07-23

Condition(s): Relapsing multiple sclerosis (RMS)
Product: Prevenar 13 suspension for injection in single dose vial pneumococcal polysaccharide conjugate vaccine (13-valent, adsorbed), Boostrix szuszpenziós injekció eloretöltött fecskendoben diphtheria, tetanus és pertussis (acelluláris összetevo) vakcina (adszorbeált, csökkentett antigén tartalmú), Boostrix szuszpenziós injekció előretöltött fecskendőben diphtheria, tetanus és pertussis (acelluláris összetevő) vakcina (adszorbeált, csökkentett antigén tartalmú), Pneumovax 23 oldatos injekció előretöltött fecskendőben Pneumococcus-poliszacharid vakcina, Flucelvax Tetra - suspension for injection in pre-filled syringe Influenza vaccine (surface antigen, inactivated, prepared in cell cultures), PNEUMOVAX 23 Injektionslösung in einer Durchstechflasche Pneumokokken-Polysaccharid-Impfstoff, PNEUMOVAX solution injectable en flacon Vaccin pneumococcique polyosidique, Boostrix szuszpenziós injekció előretöltött fecskendőben diphtheria, tetanus és pertussis (acelluláris összetevő) vakcina (adszorbeált, csökkentett antigén tartalmú), PNEUMOVAX 23 Szczepionka przeciw pneumokokom, polisacharydowa, roztwór do wstrzykiwań, Pneumovax 23 oldatos injekció Pneumococcus-poliszacharid vakcina, Boostrix* Diphtherie-Tetanus-Pertussis (azellular)-Kombinationsimpfstoff zur Auffrischimpfung, Pneumovax 23 oldatos injekció előretöltött fecskendőben Pneumococcus-poliszacharid vakcina, Pneumovax 23 otopina za injekciju u napunjenoj štrcaljki Cjepivo protiv pneumokoka, polisaharidno, PNEUMOVAX solution injectable en flacon Vaccin pneumococcique polyosidique, BOOSTRIX, suspension injectable en seringue préremplie Vaccin diphtérique, tétanique et coquelucheux (acellulaire multicomposé), (adsorbé, à teneur réduite en antigènes), BOOSTRIX, suspension injectable en seringue préremplie Vaccin diphtérique, tétanique et coquelucheux (acellulaire multicomposé), (adsorbé, à teneur réduite en antigènes), Boostrix suspensión inyectable en jeringa precargada Vacuna antidiftérica, antitetánica y antitos ferina (componente acelular) (adsorbida, contenido antigénico reducido), Boostrix Injektionssuspension in einer Fertigspritze Diphtherie-, Tetanus- und Pertussis (azellulär, aus Komponenten)-Adsorbatimpfstoff (mit reduziertem Antigengehalt), Kesimpta 20 mg solution for injection in pre-filled pen, Flucelvax Tetra - suspension for injection in pre-filled syringe Influenza vaccine (surface antigen, inactivated, prepared in cell cultures), Kesimpta 20 mg solution for injection in pre-filled pen, Pneumovax 23 oldatos injekció előretöltött fecskendőben Pneumococcus-poliszacharid vakcina, PNEUMOVAX solution injectable en flacon Vaccin pneumococcique polyosidique, BOOSTRIX, suspension injectable en seringue préremplie Vaccin diphtérique, tétanique et coquelucheux (acellulaire multicomposé), (adsorbé, à teneur réduite en antigènes), Pneumovax 23 oldatos injekció Pneumococcus-poliszacharid vakcina, Pneumovax 23 oldatos injekció előretöltött fecskendőben Pneumococcus-poliszacharid vakcina, Pneumovax 23 oldatos injekció előretöltött fecskendőben Pneumococcus-poliszacharid vakcina, Boostrix, suspenzija za injekciju u napunjenoj štrcaljki, cjepivo protiv difterije, tetanusa i pertusisa (nestanicno, komponentno), adsorbirano, smanjenog(ih) sadržaja antigena, PNEUMOVAX 23 Solución inyectable en vial Vacuna antineumocócica de polisacáridos, Boostrix zawiesina do wstrzykiwań w ampułko-strzykawce|Szczepionka przeciw błonicy, tężcowi i krztuścowi (bezkomórkowa, złożona), adsorbowana, o|zmniejszonej zawartości antygenów, Pneumovax 23 oldatos injekció előretöltött fecskendőben Pneumococcus-poliszacharid vakcina

Primary endpoint: Proportion of subjects with adverse events, Proportion of subjects with laboratory, or vital signs results meeting abnormal criteria, Proportion of subjects with electrocardiogram (ECG) meeting abnormal criteria [through Week 240 (EOS)], Proportion of subjects meeting predefined criteria in Columbia Suicide Severity Rating Scale (C SSRS) [through Week 240/EOS]
Endpoint(s): Through Week 240/EOS: • Annualized Relapse Rate (ARR), Through Week 240/EOS: • Time to first relapse, Through Week 240/EOS: • Time to 3-month Confirmed Disability Worsening (3mCDW), Through Week 240/EOS: • Time to 6-month Confirmed Disability Worsening (6mCDW), Through Week 240/EOS: • Time to 6-month Confirmed Disability Improvement (6mCDI), Through Week 240/EOS: • Time to 12-month Confirmed Disability Improvement (12mCDI), Through Week 240/EOS: • Time to 24-month Confirmed Disability Improvement (24mCDI), Through Week 240/EOS: • Time to 6-month Confirmed Disability Improvement (6mCDI) sustained until End of Study (EOS), Through Week 240/EOS: • Change in Expanded Disability Status Scale (EDSS), Through Week 240/EOS: • Time to 6-month confirmed 4-point worsening on Symbol Digit Modalities Test (SDMT), Through Week 240/EOS: • Change in SDMT, Through Week 240/EOS: • Annualized T2 lesion rate, Through Week 240/EOS: • Number of T1 Gd-enhancing lesions per Magnetic Resonance Image (MRI) scan, Through Week 240/EOS: • Annual rate of change in brain volume, Through Week 240/EOS: • Change in neurofilament light chain (NfL) concentration in serum, Through Week 240/EOS: • Relationship between NFL and disease activity, disease course and treatment response, Through Week 240/EOS: • Patient Reported Outcomes (PRO)

Source: https://euclinicaltrials.eu/ctis-public/view/2023-507906-15-00